EU clinical trial 2024-511904-18-00: GEMFOX - Randomized phase 3 trial comparing FOLFOX to gemcitabine in metastatic first-line in patients with pancreatic adenocarcinoma and non-fit for FOLFIRINOX
Protocol code: D20180177
Sponsor: Assistance Publique Hopitaux De Paris (Hospital/Clinic/Other health care facility). Phase: Phase II and Phase III (Integrated). Countries: France (ongoing, recruiting).
Therapeutic area(s): Diseases [C] - Neoplasms [C04]
Gender: Female, Male. Age: 18-64 years, 65+ years. Enrolment: 400.
Status: Ongoing, recruiting. Start date (EU): 2020-07-08. Decision date: 2024-12-05. Results received: No. Last updated: 2025-05-22.

Condition(s): Pancreatic adenocarcinoma (PAC)
Product: FLUOROURACIL, OXALIPLATIN, GEMCITABINE, FOLIC ACID

Primary endpoint: Overall survival (OS) at 24 months
Endpoint(s): - Objective response rate and disease control rate (RECIST criteria 1.1), duration of response, duration of disease control., - Progression-free survival (PFS) will be defined as the delay between the date of inclusion and the date of the first event (progression or death) or date of last news if the patient is alive without any progression., - Ca 19-9 and CEA levels, at inclusion and their dynamic change under treatment., - Toxicities will be described by type of toxicities and grades according to International Common Terminology Criteria for Adverse Events (CTCAE) version 5.0., - Safety: rate of serious adverse events, grade 3-4 toxicities (hematologic and non-hematologic). Adverse events will be graded according to the National Cancer Institute Common Terminology Criteria for Adverse Events (NCI CTCAE) version 5.0., - Quality of life will be studied by means of the EORTC QLQ C-30 questionnaire, the health-related quality of life (HRQoL) and the consensual geriatric minimum data set (SOFOG) for patients ≥75 years and, - The dose-intensity (DI) of each protocol will be calculated based on the number of cycles received by each patient. The relative DI will be calculated as the ratio of the DI to the DI indicated in the protocol (obtained as the dose specified per cycle in mg/m²)., - The Quality-adjusted Time WIthout Symptoms of disease or Toxicity (Q-TWIST), - Type of second-line and third-line regimens and the date of beginning of first-cycle of each line will be collected.

Source: https://euclinicaltrials.eu/ctis-public/view/2024-511904-18-00